EU clinical trial 2024-510603-11-00: ION373-CS1: A Phase 1-3, Double-Blind, Randomized, Placebo-Controlled Study to Evaluate the Efficacy, Safety, Pharmacokinetics and Pharmacodynamics of Intrathecally Administered ION373 in Patients with Alexander Disease
Protocol code: ION373-CS1
Sponsor: Ionis Pharmaceuticals Inc. (Pharmaceutical company). Phase: Phase I and Phase II (Integrated)- First administration to humans. Countries: Netherlands (ongoing, recruitment ended), Italy (ongoing, recruitment ended).
Therapeutic area(s): Diseases [C] - Congenital, Hereditary, and Neonatal Diseases and Abnormalities [C16]
Gender: Female, Male. Age: 0-17 years, 18-64 years. Enrolment: 15.
Status: Ongoing, recruitment ended. Start date (EU): 2021-04-08. Decision date: 2024-05-28. Results received: No. Last updated: 2026-06-26.
Decision dates by country: NL: 2024-05-28, IT: 2024-06-24

Condition(s): Alexander Disease
Product: Artificial Cerebrospinal Fluid (aCSF) for injection, ION373

Primary endpoint: Percent change from Baseline to Week 61 in the 10MWT in patients who are in Stratum 1.
Endpoint(s): Change from Baseline to Week 61 or value at Week 61 for the following: • Patients' self-identified most bothersome symptom (based on a Likert scale for change; all patients) • PedsQL Generic Core Scales (all patients) • Patient Global Impression of Severity (PGIS; all patients) • Patient Global Impression of Change (PGIC; all patients) • Clinical Global Impression of Change (CGIC; all patients), Change from Baseline to Week 61 or value at Week 61 for the following: • Gross Motor Function Measure-88, Dimensions C, D and E (GMFM-88, Dimensions C-E; patients < 5 years old at Screening) or 10MWT (patients ≥ 5 years old at Screening) • 9-Hole Peg Test (9HPT; patients ≥ 8 years old at Screening) • Vineland-3 Motor Skills Domain (patients < 8 years old at Screening) • PedsQL Gastrointestinal Symptoms Scales (all patients), Change from Baseline to Week 61 or value at Week 61 for the following: Vineland-3 Adaptive Behavior Composite (ABC) Score (patients < 18 years old at Screening) • Composite Autonomic Symptom Score 31 (COMPASS-31; patients ≥ 18 years old at Screening) • CSF GFAP levels (all patients) • Clinical Global Impression of Severity (CGIS; all patients), Change from Baseline to Week 61 or value at Week 61 for the following: • Alexander Disease Patient Domain Impression of Severity (AxD-PDIS; all patients) •Alexander Disease Patient Domain Impression of Change (AxD-PDIC; all patients) • Body weight percentile (for patients < 18 years old at Screening) or body weight (for patients ≥ 18 years old at Screening

Source: https://euclinicaltrials.eu/ctis-public/view/2024-510603-11-00